EU clinical trial 2025-521279-30-00: A study in healthy men to test whether carbamazepine influences the amount of nerandomilast in the blood
Protocol code: 1305-0119
Sponsor: Boehringer Ingelheim International GmbH (Pharmaceutical company). Phase: Human Pharmacology (Phase I)- Other. Countries: Germany (ended).
Therapeutic area(s): Not possible to specify
Gender: Male. Age: 18-64 years. Enrolment: 16.
Status: Ended. Start date (EU): 2025-08-06. End date (EU): 2025-10-01. Decision date: 2025-06-26. Results received: No. Last updated: 2025-06-26.

Condition(s): Healthy volunteer trial

Source: https://euclinicaltrials.eu/ctis-public/view/2025-521279-30-00